EU clinical trial 2025-523438-24-00: A Multicenter Study Evaluating the Safety, Efficacy, and Pharmacokinetics of IDE849 in Patients with DLL3 Expressing Tumors Including Small Cell Lung Cancer
Protocol code: IDE849-001
Sponsor: Ideaya Biosciences Inc. (Pharmaceutical company). Phase: Phase I and Phase II (Integrated)- Other. Countries: France (authorised, recruitment pending), Spain (authorised, recruitment pending).
Therapeutic area(s): Diseases [C] - Neoplasms [C04]
Gender: Female, Male. Age: 18-64 years, 65+ years. Enrolment: 35.
Status: Authorised, recruitment pending. Decision date: 2026-07-01. Results received: No. Last updated: 2026-07-30.
Decision dates by country: ES: 2026-07-03, FR: 2026-07-30

Condition(s): DLL3 Expressing Tumors Including Small Cell Lung Cancer
Product: IDE161, IDE849, IDE161, IMFINZI 50 mg/mL concentrate for solution for infusion

Primary endpoint: Safety endpoints: incidence of DLT; incidence and severity of AEs/SAEs (graded based on CTCAE version 5.0); Efficacy endpoints: ORR, CR + PR and DOR per RECIST version 1.1 as assessed by the Investigator
Endpoint(s): Efficacy endpoints: objective response (ORR) and DOR per RECIST version 1.1 • Pharmacokinetic endpoints: blood concentrations and PK parameters of the ADC, total antibody (TAb), and unconjugated payload (IDC-0029701) • Immunogenicity endpoint: anti IDE849 antibody (antidrug antibody [ADA]) incidence and titer

Source: https://euclinicaltrials.eu/ctis-public/view/2025-523438-24-00